EU clinical trial 2024-514720-17-00: To evaluate the efficacy and safety of regorafenib in patients with refractory primary bone tumors.
Protocol code: REGBONE
Sponsor: Instytut Matki I Dziecka (Hospital/Clinic/Other health care facility). Phase: Therapeutic exploratory (Phase II). Countries: Poland (ongoing, recruitment ended).
Therapeutic area(s): Diseases [C] - Neoplasms [C04]
Gender: Female, Male. Age: 0-17 years, 18-64 years. Enrolment: 30.
Status: Ongoing, recruitment ended. Start date (EU): 2022-04-29. Decision date: 2024-08-06. Results received: No. Last updated: 2024-08-06.

Condition(s): Refractory primary bone tumors
Product: REGORAFENIB

Primary endpoint: EFS - (Event-Free Survival) event-free survival - will be measured from randomization to the occurrence of: death, assertion of disease progression or recurrence, finding a secondary neoplasm., Determination of the dose of the test substance in patients between 9 and 18 years at which exposure to the drug similar to that recommended for adults will be achieved., To evaluate the safety of regorafenib by analyzing adverse events (AEs) including adverse events of special importance., Assessment of the safety of regorafenib through the analysis of recorded vital signs, laboratory test results, echocardiography, and ECG.
Endpoint(s): PFS (Progression-Free Survival) - progression-free survival - will be measured from randomization to finding disease progression in imaging studies., OS (Overall Survival) - will be measured from randomization to death due to neoplastic disease., ORR (Overall Response Rate) - Percentage of patients who achieved a protocol-defined response to treatment., Time to reach the target serum concentration of the test substance., Maximum serum concentration at steady state Cmaxs., Steady-state trough serum concentration Cminss., Casual steady-state serum concentration Css., Exposure to Ctau., Time to steady-state concentration of the test substance in the serum.

Source: https://euclinicaltrials.eu/ctis-public/view/2024-514720-17-00